EU clinical trial 2023-506638-59-01: Tapering of Rituximab Based on Interval Prolongation Compared to Disease Activity-Guided Dose Reduction in Patients with Rheumatoid Arthritis: The RITUXERA Trial.
Protocol code: S67309
Sponsor: UZ Leuven (Hospital/Clinic/Other health care facility). Phase: Therapeutic use (Phase IV). Countries: Belgium (ongoing, recruiting).
Therapeutic area(s): Diseases [C] - Musculoskeletal Diseases [C05]
Gender: Female, Male. Age: 18-64 years, 65+ years. Enrolment: 134.
Status: Ongoing, recruiting. Start date (EU): 2024-01-09. Decision date: 2023-11-28. Results received: No. Last updated: 2026-05-13.

Condition(s): Rheumatoid arthritis
Product: MabThera 500 mg concentrate for solution for infusion, Truxima 100 mg concentrate for solution for infusion, MabThera 100 mg concentrate for solution for infusion, Ruxience 100 mg concentrate for solution for infusion, Rixathon 500 mg concentrate for solution for infusion, Ruxience 500 mg concentrate for solution for infusion, Rixathon 100 mg concentrate for solution for infusion, Truxima 500 mg concentrate for solution for infusion

Primary endpoint: Comparison between both study arms of disease impact (Rheumatoid Arthritis Impact of Disease (RAID) questionnaire) over 104 weeks.
Endpoint(s): Comparison between both study arms of disease activity (AUC of the Disease Activity Score in 28-joints - C-reactive Protein (DAS28-CRP)) over 104 weeks., Cumulative dose of rituximab in the two trial arms over 104 weeks., Cumulative dose of glucocorticoids in the two trial arms over 104 weeks., Disease activity (AUC of the Simplified Disease Activity Index (SDAI)) in the two study arms over 104 weeks., Maintenance of disease control (DAS28-CRP ≤3.2) in both study arms., Rituximab drug retention rate in both study arms., Proportion of patients achieving a good/moderate European League Against Rheumatism (EULAR) response 12 weeks after treatment with rituximab in both study arms., Proportion of patients who tapered the dose of rituximab below 1 x 1000 mg IV in the experimental arm., Mean/median interval between administrations of rituximab in the active control arm., Proportion of patients with serious adverse events/reactions in both study arms., Proportion of patients with serious infections in both study arms.

Source: https://euclinicaltrials.eu/ctis-public/view/2023-506638-59-01